EU clinical trial 2023-505237-27-00: Randomised bioequivalence clinical trial of sacubitril/valsartan 49 mg/51 mg film-coated tablets, after a single oral dose administration to healthy volunteers under fasting conditions in crossover replicated design.
Protocol code: N-SACVAL-23-278
Sponsor: Laboratorios Normon S.A. (Pharmaceutical company). Phase: Human Pharmacology (Phase I)- Bioequivalence Study. Countries: Spain (ended).
Therapeutic area(s): Not possible to specify
Gender: Female, Male. Age: 18-64 years. Enrolment: 36.
Status: Ended. Start date (EU): 2023-06-02. End date (EU): 2023-07-20. Decision date: 2023-05-24. Results received: Yes. Last updated: 2023-05-24.

Condition(s): Healthy volunteers
Product: Entresto 49 mg/51 mg film-coated tablets, Sacubitrilo/valsartán Normon 49 mg/ 51 mg comprimidos recubiertos con película

Primary endpoint: Sacubitril AUC0-t, Sacubitril Cmax, Valsartan AUC0-t, Valsartan Cmax
Endpoint(s): Sacubitril AUC0-∞, Sacubitril Tmax, Sacubitril residual area, Valsartan AUC0-∞, Valsartan Tmax, Valsartan residual area

Source: https://euclinicaltrials.eu/ctis-public/view/2023-505237-27-00